EU clinical trial 2023-506130-67-00: A Phase 3, Multicenter, Double-Blind, Randomized, Placebo-Controlled Study to Evaluate the Efficacy and Safety of Infigratinib in Children 3 to <18 Years of Age with Achondroplasia: PROPEL 3
Protocol code: QBGJ398-303
Sponsor: QED Therapeutics Inc., Qed Therapeutics Inc. (Pharmaceutical company). Phase: Therapeutic confirmatory (Phase III). Countries: Spain (ended), France (ended), Germany (ended), Norway (ended), Italy (ended).
Therapeutic area(s): Phenomena and Processes [G] - Genetic Phenomena [G05]; Diseases [C] - Musculoskeletal Diseases [C05]
Gender: Female, Male. Age: 0-17 years. Enrolment: 62.
Status: Ended. Start date (EU): 2024-08-20. End date (EU): 2025-12-13. End date: 2025-12-18. Decision date: 2024-03-18. Results received: Yes. Last updated: 2025-12-05.
Decision dates by country: DE: 2024-03-20, ES: 2024-03-18, FR: 2024-03-20, IT: 2024-09-02, NO: 2024-03-19

Condition(s): Achondroplasia
Product: PLACEBO TO MATCH INFIGRATINIB SPRINKLE CAPSULES, INFIGRATINIB, INFIGRATINIB, INFIGRATINIB, INFIGRATINIB, Infigratinib

Primary endpoint: Change from baseline (BL) in AHV, compared to placebo [Time Frame: Week 52]
Endpoint(s): Change from BL in height Z-score (in relation to ACH tables), compared to placebo [Time Frame: Week 52], Change from BL in upper to lower body segment ratio, compared to placebo [Time Frame: Week 52], Change from BL in height Z-score (in relation to non-ACH tables), compared to placebo [Time Frame: Week 52], AVH compared to placebo [Time Frame: Week 52], Absolute and change from baseline in upper arm to forearm length ratio (cm), compared to placebo [Time Frame: Week 52], Absolute and change from baseline in upper leg to lower leg length ratio (cm), compared to placebo [Time Frame: Week 52], Absolute and change from baseline in arm span (cm) to standing height ratio, compared to placebo [Time Frame: Week 52], Absolute and change from baseline in head circumference (cm) to standing height ratio, compared to placebo [Time Frame: Week 52], Absolute value and change in body mass index, compared to placebo [Time Frame: Week 52], Incidence of adverse events [Time Frame: Week 52], Change from BL in AHV in children ≥5 years of age, compared to placebo [Time Frame: Week 52], Change from BL in the Physical Functioning Scale of the PedsQL child report compared to placebo [Time Frame: Week 52], Change in psychomotor function assessed by age-appropriate computerized tests (Detection Test), compared to placebo [Time Frame: Week 52], Change from BL in attention assessed by age-appropriate computerized tests (Identification Test) [Time Frame: Week 52], Change from BL in visual learning assessed by age-appropriate computerized tests (One Card Learning Test) [Time Frame: Week 52], Change from BL in working memory assessed by age-appropriate computerized tests (One Back Test) [Time Frame: Week 52], Pharmacokinetic profile of infigratinib by assessment of maximum concentration (Cmax) [Time Frame: Week 52], Pharmacokinetic profile of infigratinib by assessment of time-to-maximum concentration (Tmax) [Time Frame: Week 52], Change from BL in pharmacodynamic parameters by assessing collagen X marker, compared to placebo [Time Frame: Week 52], Evaluate the acceptability and palatability of infigratinib using a 5-point hedonic scale [Time Frame: Week 13]

Source: https://euclinicaltrials.eu/ctis-public/view/2023-506130-67-00